EU clinical trial 2022-502038-23-00: Repurposing colchicine for reduction of residual inflammatory risk in type 1 diabetes (REC1TE): a randomized, double-blind, placebo-controlled, investigator-initiated trial
Protocol code: The REC1TE trial
Sponsor: Gentofte Hospital (Hospital/Clinic/Other health care facility). Phase: Therapeutic exploratory (Phase II). Countries: Denmark (ongoing, recruitment ended).
Therapeutic area(s): Diseases [C] - Cardiovascular Diseases [C14]; Diseases [C] - Hormonal diseases [C19]; Diseases [C] - Nutritional and Metabolic Diseases [C18]
Gender: Female, Male. Age: 18-64 years, 65+ years. Enrolment: 0.
Status: Ongoing, recruitment ended. Start date (EU): 2023-08-25. Decision date: 2023-01-10. Results received: No. Last updated: 2026-04-21.

Condition(s): Type 1 diabetes
Product: Placebo for colchicine, Colrefuz, tabletter

Primary endpoint: Estimated treatment difference in high-sensitivity C-reactive protein (mg/l) for colchicine as compared with placebo after 26 weeks of treatment
Endpoint(s): High-sensitivity C-reactive protein (mg/l) (measured at week 30), Glycated haemoglobin (mmol/mol; %-point), Time spent in target glycemia (3.9–10 mmol/l) (% of 24 hours) as assessed by continuous glucose monitoring, Time spent in hyperglycaemia level 1 (10–13.9 mmol/l) (% of 24 hours) as assessed by continuous glucose monitoring, Time spent in hyperglycaemia level 2 (> 13.9 mmol/l) (% of 24 hours) as assessed by continuous glucose monitoring, Time spent in hypoglycaemia level 1 (3.0–3.8 mmol/l) (% of 24 hours) as assessed by continuous glucose monitoring, Time spent in hypoglycaemia level 2 (< 3.0 mmol/l) (% of 24 hours) as assessed by continuous glucose monitoring, Insulin dosage, long-acting (units/day), Insulin dosage, short-acting (units/day), Body weight (kg), Waist:hip ratio, Low-density lipoprotein cholesterol (mmol/l), Interleukin-6 (pg/ml), Tumour necrosis factor alpha (pg/ml), Serious adverse events (SAE), Events of severe hypoglycemia, Events of diabetic ketoacidosis

Source: https://euclinicaltrials.eu/ctis-public/view/2022-502038-23-00